EU clinical trial 2022-502539-21-00: An Open-Label Uncontrolled Multicenter Study to Evaluate the Pharmacokinetics, Pharmacodynamics, Safety and Activity of Nipocalimab in Children Aged 2 to less than 18 years with Generalized Myasthenia Gravis
Protocol code: 80202135MYG2001
Sponsor: Janssen - Cilag International (Pharmaceutical company). Phase: Phase II and Phase III (Integrated). Countries: Netherlands (ongoing, recruiting), Poland (ongoing, recruiting).
Therapeutic area(s): Diseases [C] - Musculoskeletal Diseases [C05]
Gender: Female, Male. Age: 0-17 years. Enrolment: 3.
Status: Ongoing, recruiting. Start date (EU): 2022-10-21. Decision date: 2023-07-17. Results received: No. Last updated: 2026-04-21.
Decision dates by country: PL: 2023-08-21, NL: 2023-07-17

Condition(s): Myasthenia gravis (MG)
Product: JNJ-80202135

Primary endpoint: The effect of nipocalimab on total serum IgG in pediatric participants 2 to <18 years of age with gMG who have an insufficient clinical response to ongoing, stable standard-of-care therapy., The safety and tolerability of treatment with nipocalimab in pediatric participants 2 to <18 years of age with gMG who have an insufficient clinical response to ongoing, stable standardof- care therapy., The pharmacokinetics of nipocalimab in pediatric participants 2 to <18 years of age with gMG who have an insufficient clinical response to ongoing, stable standard of care therapy., All primary PK and IgG endpoints will be summarized descriptively over time for the evaluable population, and for each age cohort (2 to <12, or 12 to <18 years old).

Source: https://euclinicaltrials.eu/ctis-public/view/2022-502539-21-00